EU clinical trial 2024-515933-14-00: Phase I single-blind clinical trial to evaluate the safety and local immune activation of a toll-like receptor 5 agonist (FLAMOD) administered by aerosol
Protocol code: C20-48
Sponsor: Institut National De La Sante Et De La Recherche Medicale (Laboratory/Research/Testing facility). Phase: Human Pharmacology (Phase I)- First administration to humans. Countries: France (ended).
Therapeutic area(s): Diseases [C] - Respiratory Tract Diseases [C08]; Diseases [C] - Bacterial Infections and Mycoses [C01]
Gender: Female, Male. Age: 18-64 years, 65+ years. Enrolment: 60.
Status: Ended. Start date (EU): 2025-04-14. End date (EU): 2026-04-17. Decision date: 2024-10-24. Results received: No. Last updated: 2025-03-20.

Condition(s): Pneumonia

Source: https://euclinicaltrials.eu/ctis-public/view/2024-515933-14-00